EU clinical trial 2023-507744-36-00: The effect of naldemedine on opioid-induced bowel dysfunction
Sponsor: Aalborg University Hospital (Hospital/Clinic/Other health care facility). Phase: Therapeutic exploratory (Phase II). Countries: Denmark (ongoing, recruiting).
Therapeutic area(s): Diseases [C] - Digestive System Diseases [C06]
Gender: Male. Age: 18-64 years. Enrolment: 20.
Status: Ongoing, recruiting. Start date (EU): 2024-08-12. Decision date: 2023-12-11. Results received: No. Last updated: 2026-05-01.

Condition(s): Opioid induced bowel dysfunction
Product: Tramadol HCl Retard Mylan 100 mg, tabletten met verlengde afgifte, Matching filmcoated placebo tablets will be provided by Shionogi, Rizmoic 200 micrograms film-coated tablets

Primary endpoint: • Total GI transit time (MTS-2), • Colorectal transit time (MTS-2)
Endpoint(s): • Subjective assessments of constipation (PAC-SYM, BSFS, GSRS, BFI), • Diagnostic evaluation of opioid-induced constipation (Rome IV C6), • Subjective assessment of opiate withdrawal (SOWS), • Segmental transit time of the stomach, small intestine, and colonic segments (assessed with MTS-2), • Detailed colonic motility (assessed with 3D-Transit), • Colon volume (assessed with MRI), • Water content in the colon (assessed with MRI), • Rear-front pressures and defecation indices (measured by Fecobionics)

Source: https://euclinicaltrials.eu/ctis-public/view/2023-507744-36-00